EU clinical trial 2024-511898-30-00: Impact of post-Acute respiratory distress syndrome COVID sedation on late neuroinflammation (PET-DEXDOCOVID)
Protocol code: APHP200491
Sponsor: Assistance Publique Hopitaux De Paris (Hospital/Clinic/Other health care facility). Phase: Therapeutic confirmatory (Phase III). Countries: France (ended).
Therapeutic area(s): Diseases [C] - Nervous System Diseases [C10]; Diseases [C] - Virus Diseases [C02]
Gender: Female, Male. Age: 18-64 years, 65+ years. Enrolment: 72.
Status: Ended. End date (EU): 2025-09-04. Decision date: 2024-10-04. Results received: No. Last updated: 2024-11-27.

Condition(s): Patients who survive a COVID ARDS in intensive care must be weaned off invasive mechanical ventilation as quickly as possible. 60% of these patients present with intensive care delirium, a serious event that causes excess mortality and potential acute and late complications, since 30% of patients who present with delirium develop cognitive sequelae. Severe neuroinflammation is considered to be one of the main pathophysiological mechanisms causing delirium during ventilatory weaning. In addition to its sedative properties, dexmedetomidine has neuroprotective effects. In certain experimental models, it reduces cerebral inflammation by acting directly on the microglial phenotype. The role of this chronic neuroinflammatory state on cognitive capacity and reserve is beginning to emerge in the literature, regardless of the initial stress (surgery, head injury or Alzheimer's-type dementia), and is therefore capable of influencing patients' quality of life. The assessment of this neuroinflammation using non-invasive tools would appear to be of prime importance in the management of post-COVID neuro injured patients, as well as the evaluation of potential neuroprotective agents such as dexmedetomidine.
Product: DEXMEDETOMIDINE, 18F-DPA-714

Primary endpoint: Persistent neuroinflammation is measured by the intensity of the [18F]-DPA-714 signal obtained in PET-MRI imaging at 24 months (+24 months) after discharge from intensive care on the 2 frontal lobes (freesurfer segmentation, the signal intensity being the ratio of the measurement made in the frontal lobes to that made in the cerebellar lobes. Standard fixation will be expressed as an indexed value relative to the control value., The intensity of the [18F]-DPA-714 signal is the standard uptake value which will be measured in each region of interest (frontal lobes and cerebellar lobes = reference) and related to the quantity of radioactivity injected for the examination. The ratio of SUV in the frontal lobes to SUV in the cerebellar lobes will give us the radioligand uptake ratio for the area of interest.
Endpoint(s): - To evaluate the effect of dexmedetomidine treatment on acquired neurocognitive damage using clinical assessment scores at 24 months (+24 months) after discharge from intensive care of patients hospitalised for ARDS with COVID-19 ;, - To evaluate the effect of dexmedetomidine treatment on neurocognitive lesions acquired with diffusion tensor brain MRI at 24 months (+24 months) after discharge from intensive care following COVID ARDS., - To assess the association between immunological, transcriptomic and epigenomic biological data likely to promote or protect against the persistence of a neuroinflammatory state remote from a severe COVID-19 infection 24 months (+24 months) after discharge from intensive care., - To identify the clinical and pharmacological risk factors (in particular the sedative treatments used for ventilatory weaning) for the occurrence of late neuroinflammation defined by an increase in DPA on PET-MRI in the frontal lobes and other regions of interest at 24 months (+24 months) after discharge from intensive care

Source: https://euclinicaltrials.eu/ctis-public/view/2024-511898-30-00